EU clinical trial 2023-510171-59-00: Comparison of the study drug CHF 1535 formulated with two different propellants to learn about drug levels in blood and safety after inhalation, with and without the use of the Aerochamber Plus® spacer, in healthy volunteers.
Protocol code: CLI-01535AA7-04
Sponsor: Chiesi Farmaceutici S.p.A. (Pharmaceutical company). Phase: Human Pharmacology (Phase I)- Other. Countries: Belgium (ended).
Therapeutic area(s): Diseases [C] - Respiratory Tract Diseases [C08]
Gender: Female, Male. Age: 18-64 years. Enrolment: 90.
Status: Ended. Start date (EU): 2024-06-17. End date (EU): 2024-10-30. Decision date: 2024-06-17. Results received: No. Last updated: 2024-06-17.

Condition(s): Asthma and chronic obstructive pulmonary disease (COPD).

Source: https://euclinicaltrials.eu/ctis-public/view/2023-510171-59-00